EU clinical trial 2024-519519-32-00: A Phase II, Randomized, Trial of Niraparib Versus Best Supportive Careas Maintenance Treatment In Patients With Locally Advanced Or Metastatic Urothelial Cancer Whose Disease Did Not Progress After Completion Of First-line Platinum-containing Chemotherapy (MEET URO 12)
Protocol code: MEET-URO 12
Sponsor: Universita' Degli Studi Di Torino (Educational Institution). Phase: Therapeutic exploratory (Phase II). Countries: Italy (authorised, recruitment pending).
Therapeutic area(s): Diseases [C] - Neoplasms [C04]
Gender: Female, Male. Age: 18-64 years, 65+ years. Enrolment: 77.
Status: Authorised, recruitment pending. Decision date: 2025-01-15. Results received: No. Last updated: 2025-02-17.

Condition(s): urothelial cancer
Product: Zejula 100 mg hard capsules

Primary endpoint: Progression free survival (PFS)
Endpoint(s): Proportion of objective answers, Duration of the answer, Global survival, Proportion of progression-free patients at 6 months from randomization., Safety and tolerability, Quality of life (patient-reported outcomes)

Source: https://euclinicaltrials.eu/ctis-public/view/2024-519519-32-00